EU clinical trial 2024-512549-18-00: A randomized, double-blind, Phase 2, dose-finding trial of once weekly petrelintide compared with placebo in participants with obesity or overweight with weight related comorbidities
Protocol code: ZP8396-23094
Sponsor: Zealand Pharma A/S (Pharmaceutical company). Phase: Therapeutic exploratory (Phase II). Countries: Poland (ended), Romania (ended).
Therapeutic area(s): Diseases [C] - Nutritional and Metabolic Diseases [C18]
Gender: Female, Male. Age: 18-64 years, 65+ years. Enrolment: 220.
Status: Ended. Start date (EU): 2024-12-19. End date (EU): 2026-03-07. End date: 2026-03-08. Decision date: 2024-12-16. Results received: No. Last updated: 2026-01-16.
Decision dates by country: RO: 2024-12-16, PL: 2024-12-16

Condition(s): Weight management
Product: Placebo for petrelintide, Petrelintide, Petrelintide

Primary endpoint: Change in body weight (%) from baseline to week 28
Endpoint(s): Body weight loss of ≥5% from baseline to week 28 (Y/N), Body weight loss of ≥10% from baseline to week 28 (Y/N)

Source: https://euclinicaltrials.eu/ctis-public/view/2024-512549-18-00